EU clinical trial 2023-503887-18-00: A Single Dose, Fed state, Crossover Replicate Bioequivalence Study of NITROFURANTOIN 100 mg prolonged-release capsules (Iasis Pharma) vs. FURABID® 100 mg prolonged-release capsules (Amdipharm Limited)
Protocol code: NITRAIS 01/2023
Sponsor: Antibiotice S.A., Iasis Pharmaceuticals Hellas S.A. (Pharmaceutical company). Phase: Human Pharmacology (Phase I)- Bioequivalence Study. Countries: Romania (ended).
Therapeutic area(s): Diseases [C] - Male Urogenital Diseases [C12]; Diseases [C] - Bacterial Infections and Mycoses [C01]; Diseases [C] - Female Urogenital Diseases and Pregnancy Complications [C13]
Gender: Female, Male. Age: 18-64 years. Enrolment: 32.
Status: Ended. Start date (EU): 2023-10-02. End date (EU): 2023-11-13. Decision date: 2023-07-19. Results received: No. Last updated: 2023-07-19.

Condition(s): healthy subjects

Source: https://euclinicaltrials.eu/ctis-public/view/2023-503887-18-00